EU clinical trial 2024-516198-61-00: UNIRAD : Randomised, double-blind, multicentre phase III trial evaluating the safety and benefit of adding everolimus to adjuvant hormone therapy in women with high risk of relapse, ER+ and HER2- primary breast cancer who remain free of disease
Protocol code: UC-0140/1208
Sponsor: Unicancer (Hospital/Clinic/Other health care facility). Phase: Therapeutic confirmatory (Phase III). Countries: Belgium (ongoing, recruitment ended), France (ongoing, recruitment ended).
Therapeutic area(s): Diseases [C] - Neoplasms [C04]
Gender: Female. Age: 18-64 years, 65+ years. Enrolment: 1080.
Status: Ongoing, recruitment ended. Start date (EU): 2013-06-05. Decision date: 2024-08-29. Results received: No. Last updated: 2024-08-30.
Decision dates by country: BE: 2024-08-29, FR: 2024-08-30

Condition(s): Patients with high risk of relapse, ER+ and HER2- primary non-metastatic breast cancer who remain disease-free
Product: Afinitor 5 mg tablets, PLACEBO

Primary endpoint: Disease free survival rate (DFS) after randomisation (disease is defined as local, regional or metastatic relapse, a new contralateral breast cancer, or death from any cause).
Endpoint(s): Efficacy : Overall survival rate (OS) for the whole population, Efficacy : DFS and OS for ER+ and PR+ subgroup, Efficacy : DFS and OS for the ER+/PR – subgroup, Efficacy : EFS, Efficacy : DMFS, Efficacy : BMFS, Efficacy : Secondary cancer, Toxicity : CTC-AE scale version 4.0., Biological : Predictive value of mTOR activation markers on DFS: IHC analysis of primary tumor for pS6K and p4EBP, Biological : Other translational analyses linking cancer biology with outcomes, Other : Quality of life: QLQ C30, Other : EFS and DMFS in low risk patients (according to the EPClin score), Other : Sociologic study

Source: https://euclinicaltrials.eu/ctis-public/view/2024-516198-61-00